EU clinical trial 2022-502095-23-01: Multicenter, Prospective, Open-label, Randomized, Crossover Study to Evaluate Pharmacokinetics (PK), Safety, and Tolerability of TAK-881 in Primary Immunodeficiency Diseases (PIDD)
Protocol code: TAK-881-3001
Sponsor: Takeda Development Center Americas Inc. (Pharmaceutical company). Phase: Phase II and Phase III (Integrated). Countries: Slovakia (ended), Greece (ended), Poland (ended), Netherlands (ended), Spain (ended), Czechia (ended), Germany (ended), Denmark (ended).
Therapeutic area(s): Diseases [C] - Immune System Diseases [C20]
Gender: Female, Male. Age: 0-17 years, 18-64 years, 65+ years. Enrolment: 27.
Status: Ended. Start date (EU): 2024-09-10. End date (EU): 2026-01-20. End date: 2026-01-21. Decision date: 2024-08-26. Results received: Yes. Last updated: 2026-01-27.
Decision dates by country: DK: 2024-08-26, NL: 2024-08-30, DE: 2024-08-27, CZ: 2024-08-30, PL: 2024-08-30, SK: 2024-08-27, ES: 2024-08-30, GR: 2024-08-26

Condition(s): Primary Immunodeficiency Diseases
Product: HyQvia 100 mg/ml solution for infusion for subcutaneous use, HyQvia 100 mg/ml solution for infusion for subcutaneous use, TAK-881

Primary endpoint: The primary endpoint is AUC0-τ,ss based on total IgG levels.
Endpoint(s): Efficacy Endpoints 1. Annualized rate of all infections. 2. Annualized rate of ASBIs. 3. Annualized rate of episodes of fever. 4. Time to first ASBI. 5. Duration of infections., Health Resource Utilization Endpoints 1. Days not able to go to school, work, daycare, or to perform normal daily activities due to infections and/or their treatment, or other illnesses. 2. Days on antibiotics. 3. Number of hospitalizations, indication for the hospitalization (infection or other illnesses) and days hospitalized. 4. Number of acute physician visits due to infection or other illnesses., Pharmacokinetic Endpoints 1. Pharmacokinetics at steady-state including Cmax, Tmax, t1/2, CL/F, Vz/F, and AUC0-τ,ss/week based on total IgG levels. 2. Trough level of total IgG. 3. Trough level of IgG subclasses. 4. Trough level of antigen-specific IgG antibodies (only for subjects ≥16 years)., Safety Endpoints • Occurrence of TEAEs. • Tolerability: occurrence of infusion withdrawals, interruptions, and infusion rate reductions due to TAK-881-related TEAEs. • Immunogenicity: occurrence of positive binding (defined as titer ≥1:160) and neutralizing antibodies to rHuPH20., Note that clinically significant treatment-emergent changes in clinical laboratory measurements and vital signs will be recorded in the study database as TEAEs. Infusion Endpoints at Full Dose • Number of infusions per month. • Number of infusion sites (needle sticks) per month. • Number of infusion sites (needle sticks) per infusion. • Duration of infusions (minutes). • Monthly infusion time (minutes/month). • Maximum infusion rate per site (mL/hour/site). • Infusion volume per site (mL/site).

Source: https://euclinicaltrials.eu/ctis-public/view/2022-502095-23-01